EU clinical trial 2023-505110-14-00: A Phase 2, Randomized Study to Evaluate Safety, Efficacy, and Optimal Dose of ABBV-400 in Combination with Fluorouracil, Folinic Acid, and Bevacizumab and to Evaluate Safety and Efficacy of ABBV-400 in Combination with Bevacizumab in Previously Treated Subjects with Unresectable Metastatic Colorectal Cancer
Protocol code: M24-311
Sponsor: AbbVie Deutschland GmbH & Co. KG (Pharmaceutical company). Phase: Therapeutic exploratory (Phase II). Countries: Belgium (ongoing, recruitment ended), Germany (ongoing, recruitment ended), Spain (ongoing, recruitment ended).
Therapeutic area(s): Diseases [C] - Neoplasms [C04]
Gender: Female, Male. Age: 18-64 years, 65+ years. Enrolment: 61.
Status: Ongoing, recruitment ended. Start date (EU): 2024-12-02. Decision date: 2024-08-02. Results received: No. Last updated: 2026-02-25.
Decision dates by country: ES: 2024-08-02, DE: 2024-08-09, BE: 2024-08-08

Condition(s): Colorectal Cancer
Product: BEVACIZUMAB, IRINOTECAN, FOLINIC ACID, Telisotuzumab adizutecan, FLUOROURACIL

Primary endpoint: Objective Response as assessed by the investigator, Progression Free Survival (PFS) as assessed by the investigator
Endpoint(s): Duration of Response (DOR) as assessed by the investigator, Overall Survival (OS), Best Overall Response (BOR) as assessed by the investigator

Source: https://euclinicaltrials.eu/ctis-public/view/2023-505110-14-00